EU clinical trial 2023-507525-42-00: A Phase III, randomized, multi-site, open-label trial of BNT323/DB-1303 versus investigator’s choice of chemotherapy in previously treated patients with HER2- expressing recurrent endometrial cancer
Protocol code: BNT323-01
Sponsor: BioNTech SE (Pharmaceutical company). Phase: Therapeutic confirmatory (Phase III). Countries: Denmark (ongoing, recruiting), Poland (ongoing, recruiting), Italy (ongoing, recruiting), Finland (ongoing, recruiting), Czechia (ongoing, recruiting), Sweden (ongoing, recruiting), Greece (ongoing, recruiting), Belgium (ongoing, recruiting), Norway (ongoing, recruiting), Hungary (ongoing, recruiting), Germany (authorised, recruitment pending), Austria (authorised, recruitment pending), France (ongoing, recruiting), Spain (ongoing, recruiting), Netherlands (ongoing, recruiting).
Therapeutic area(s): Diseases [C] - Neoplasms [C04]; Diseases [C] - Female Urogenital Diseases and Pregnancy Complications [C13]
Gender: Female. Age: 18-64 years, 65+ years. Enrolment: 222.
Start date (EU): 2025-12-23. Decision date: 2025-10-27. Results received: No. Last updated: 2026-05-04.
Decision dates by country: HU: 2025-10-30, AT: 2025-11-03, BE: 2025-10-27, SE: 2025-10-29, NO: 2025-11-03, DK: 2025-10-27, PL: 2025-10-31, ES: 2025-10-30, FR: 2025-11-03, FI: 2025-10-27, IT: 2025-10-28, DE: 2025-10-30, CZ: 2025-10-29, GR: 2025-10-30, NL: 2025-11-17

Condition(s): Endometrial cancer
Product: BNT323, Ribodoxo® 2 mg/ml Injektionslösung, DOCETAXEL, Paclitaxel AqVida 6 mg/ml Konzentrat zur Herstellung einer Infusionslösung

Primary endpoint: Cohort 1: By treatment arm, PFS by BICR defined as the time from randomization to the first objective tumor progression (per RECIST 1.1) or death from any cause, whichever occurs first., Cohort 2: For BNT323 monotherapy, objective response rate (ORR) assessed by blinded independent central review (BICR), defined as the proportion of participants with a complete response (CR) or partial response (PR) (per RECIST 1.1) as best overall response with confirmation.
Endpoint(s): Cohort 1, by treatment arm: overall survival (OS) defined as the time from randomization to death from any cause., Cohort 1, by treatment arm: PFS assessed by the investigator defined as the time from randomization to the first objective tumor progression (per RECIST 1.1) or death from any cause, whichever occurs first., Cohort 1, by treatment arm: Objective response rate (ORR) defined as the proportion of participants with a complete response (CR) or partial response (PR) (per RECIST 1.1) as best overall response with confirmation., Cohort 1, by treatment arm: Duration of response (DoR) defined as the time from first objective response (CR or PR per RECIST 1.1) to first occurrence of objective tumor progression (progressive disease [PD] per RECIST 1.1) or death from any cause, whichever occurs first., Cohort 1, by treatment arm: Occurrence of treatment-emergent adverse events (TEAEs) including Grade ≥3, serious, and fatal TEAEs by relationship from the time of initiation of the first dose of trial treatment to 35 days after the last trial treatment dose., Cohort 1, by treatment arm: Occurrences of TEAEs leading to drug interruption, dose reduction, or discontinuation of trial treatment., For Cohort 2, for BNT323 monotherapy: ORR assessed by the investigator, defined as the proportion of participants with a CR or PR (per RECIST 1.1) as best overall response with confirmation., For Cohort 2, for BNT323 monotherapy: DoR defined as the time from first objective response (CR or PR per RECIST 1.1) to first occurrence of objective tumor progression (PD per RECIST 1.1) or death from any cause, whichever occurs first., For Cohort 2, for BNT323 monotherapy: PFS defined as the time from the first dose of trial treatment to the first objective tumor progression (per RECIST 1.1) or death from any cause, whichever occurs first., For Cohort 2, for BNT323 monotherapy: OS defined as the time from the first dose of trial treatment to death from any cause., For Cohort 2, for BNT323 monotherapy: Occurrence of treatment-emergent adverse events (TEAEs) including Grade ≥3, serious, and fatal TEAEs by relationship from the time of initiation of the first dose of trial treatment to 35 days after the last trial treatment dose., For Cohort 2, for BNT323 monotherapy: Occurrences of TEAEs leading to drug interruption, dose reduction, or discontinuation of trial treatment.

Source: https://euclinicaltrials.eu/ctis-public/view/2023-507525-42-00